EU clinical trial 2023-509665-20-00: ADP-TILIL7
Protocol code: MM2319
Sponsor: Herlev Hospital (Hospital/Clinic/Other health care facility). Phase: Human Pharmacology (Phase I)- First administration to humans. Countries: Denmark (ongoing, recruiting).
Therapeutic area(s): Diseases [C] - Neoplasms [C04]
Gender: Female, Male. Age: 18-64 years, 65+ years. Enrolment: 10.
Status: Ongoing, recruiting. Start date (EU): 2024-08-15. Decision date: 2024-03-19. Results received: No. Last updated: 2024-06-25.

Condition(s): Locally advanced or metastatic melanoma

Source: https://euclinicaltrials.eu/ctis-public/view/2023-509665-20-00